EU clinical trial 2022-500568-37-00: BOTOX® (Botulinum toxin type A) for the Reduction of Masseter Muscle Prominence: A Phase 3, Multicenter, Randomized, Double-Blind, Placebo-Controlled Study
Protocol code: M23-123
Sponsor: Abbvie Deutschland GmbH & Co. KG (Pharmaceutical company). Phase: Therapeutic confirmatory (Phase III). Countries: Belgium (ended), Italy (ended), Bulgaria (ended), France (ended), Germany (ended), Netherlands (ended), Spain (ended).
Therapeutic area(s): Not possible to specify
Gender: Female, Male. Age: 18-64 years, 65+ years. Enrolment: 199.
Status: Ended. Start date (EU): 2023-10-11. End date (EU): 2025-10-29. Decision date: 2023-02-06. Results received: No. Last updated: 2025-11-20.
Decision dates by country: NL: 2023-02-13, DE: 2023-02-09, BE: 2023-02-06, ES: 2023-02-09, IT: 2023-02-09, BG: 2023-02-13, FR: 2023-02-09

Condition(s): Masseter Muscle Prominence
Product: BOTOX 100 Allergan Units Powder for Solution for Injection, Placebo for Botox - Solution for Injection

Primary endpoint: Achievement of MMPS ≥ 2-grade improvement from baseline at Day 90, per investigator assessment of MMP, Achievement of MMPS-P ≥ 2-grade improvement from baseline at Day 90, per subject assessment of MMP
Endpoint(s): Response on the LFSQ-TXSAT follow-up version at Day 90, Response of on the BIA-MMP at Day 90, Change from baseline in lower facial volume (cm3) at Day 90, calculated from standardized images, Change from baseline in lower facial width (mm) at Day 90, calculated from standardized images, Change from baseline in Lower Facial Shape Questionnaire - Impact Assessment (LFSQ-IA) summary score at Day 90, Response of on the LFSQ-TXSAT follow-up version, Response on the BIA-MMP, Change from baseline in LFSQ-IA summary score

Source: https://euclinicaltrials.eu/ctis-public/view/2022-500568-37-00